EU clinical trial 2024-520333-68-00: A Randomized, Double-Blind, Placebo-controlled Multicenter Study to Assess the Efficacy and Safety of Milsaperidone as Adjunctive Therapy in the Treatment of Patients with Major Depressive Disorder
Protocol code: VP-VHX-896-3201
Sponsor: Vanda Pharmaceuticals Netherlands B.V. (Pharmaceutical company). Phase: Therapeutic confirmatory (Phase III). Countries: Poland (ongoing, recruiting), Czechia (ongoing, recruiting), Bulgaria (ongoing, recruiting), Germany (authorised, recruitment pending).
Therapeutic area(s): Psychiatry and Psychology [F] - Mental Disorders [F03]
Gender: Female, Male. Age: 18-64 years. Enrolment: 335.
Start date (EU): 2025-09-26. Decision date: 2025-06-10. Results received: No. Last updated: 2026-08-03.
Decision dates by country: BG: 2025-06-16, CZ: 2025-06-10, DE: 2026-08-03, PL: 2025-06-16

Condition(s): Major Depressive Disorder
Product: Milsaperidone, Placebo will be provided in size and appearance identical to those containing milsaperidone and will be administered orally., Milsaperidone, Milsaperidone

Primary endpoint: Change from Baseline in Montgomery-Asberg Depression Rating Scale (MADRS)

Source: https://euclinicaltrials.eu/ctis-public/view/2024-520333-68-00